EU clinical trial 2025-524164-37-00: An Open-Label Study to Evaluate Pharmacokinetics, Safety, Tolerability, Immunogenicity and Pharmacodynamic Effects of Subcutaneous Ocrelizumab Administration in Children and Adolescents with Relapsing-Remitting Multiple Sclerosis
Protocol code: BA45841
Sponsor: F. Hoffmann-La Roche AG (Pharmaceutical company). Phase: Therapeutic exploratory (Phase II). Countries: Poland (authorised, recruitment pending), Germany (authorised, recruitment pending), France (authorised, recruitment pending).
Therapeutic area(s): Diseases [C] - Nervous System Diseases [C10]
Gender: Female, Male. Age: 0-17 years. Enrolment: 9.
Status: Authorised, recruitment pending. Decision date: 2026-06-23. Results received: No. Last updated: 2026-06-26.
Decision dates by country: FR: 2026-06-23, DE: 2026-06-23, PL: 2026-06-26

Condition(s): Relapsing-Remitting Multiple Sclerosis (RRMS)
Product: Ocrevus 920 mg solution for injection, Ocrevus

Primary endpoint: Peak concentration (Cmax) and area under the concentration-time curve over a dosing interval (AUCtau) after the first SC injection
Endpoint(s): Rate and nature of adverse events, with severity determined according to the National Cancer Institute Common Terminology Criteria for Adverse Events (NCI CTCAE) version 5.0, Change from baseline in selected vital signs and clinical significant abnormalities in ECG, Change from baseline in selected clinical laboratory test results, Rate of study treatment discontinuation due to adverse events, Levels of CD19+ B cell count in blood, Incidence of treatment-emergent anti-drug antibodies (ADAs) during the study relative to the presence of ADAs at baseline, The relationship between ADA status and pharmacokinetics and safety

Source: https://euclinicaltrials.eu/ctis-public/view/2025-524164-37-00